EU clinical trial 2024-519593-39-00: SWE-NEO: Swedish NeoAdjuvant Trial Comparing anti-PD-1 Monotherapy to Combined anti-CTLA-4/anti-PD-1 blockade in Resectable Stage III Melanoma
Sponsor: Karolinska University Hospital (Hospital/Clinic/Other health care facility). Phase: Therapeutic confirmatory (Phase III). Countries: Sweden (ongoing, recruiting).
Therapeutic area(s): Diseases [C] - Neoplasms [C04]
Gender: Female, Male. Age: 18-64 years, 65+ years. Enrolment: 128.
Status: Ongoing, recruiting. Start date (EU): 2025-06-10. Decision date: 2025-05-05. Results received: No. Last updated: 2025-05-05.

Condition(s): Malignant melanoma stage III
Product: YERVOY 5 mg/ml concentrate for solution for infusion, OPDIVO 10 mg/mL concentrate for solution for infusion.

Primary endpoint: Event-free survival (EFS), defined as time from randomization to melanoma progression (irresectable stage III or stage IV disease), melanoma recurrence, or death from any cause (treatment-related, melanoma related or any other).
Endpoint(s): Relapse-free survival (RFS), defined as time between date of surgery and date of melanoma recurrence, treatment-related death or melanoma-related death, whichever occurs first., Distant metastasis-free survival (DMFS), defined as time between date of randomization and date of first distant metastasis, treatment-related death or melanoma-related death, whichever occurs first., Overall survival (OS), defined as time between date of randomization and date of death., Major pathological response (MPR) (≤10% viable tumor cells), difference in MPR between combined ICI and monotherapy, central review of all surgical specimens by three expert melanoma pathologists., Correlation of pathologic response in each arm to RFS, DMFS, and OS., Correlation of radiological and clinical response evaluation to RFS, DMFS, and OS., Proportion of patients having surgery according to plan (within 10 weeks from first neoadjuvant course)., Surgical complication rates according to Clavien-Dindo surgical classification., Frequency and duration of all grade and grade 3-5 treatment-related adverse events (AEs) according to CTCAE 5.0.

Source: https://euclinicaltrials.eu/ctis-public/view/2024-519593-39-00